EU clinical trial 2022-501352-28-00: A randomized, placebo-controlled, double-blind, multi-center, phase III trial to assess the efficacy and safety of trimodulin (BT588) in adult hospitalized subjects with severe community-acquired pneumonia (sCAP)
Protocol code: 996
Sponsor: Biotest GmbH & Co. KGaA (Pharmaceutical company). Phase: Therapeutic confirmatory (Phase III). Countries: Romania (ongoing, recruiting), Ireland (ongoing, recruiting), Germany (ongoing, recruiting), Spain (ongoing, recruiting), Belgium (ongoing, recruiting), Austria (ended), Hungary (ongoing, recruiting), Czechia (ongoing, recruiting), France (ongoing, recruiting).
Therapeutic area(s): Diseases [C] - Respiratory Tract Diseases [C08]
Gender: Female, Male. Age: 18-64 years, 65+ years. Enrolment: 275.
Start date (EU): 2023-06-07. Decision date: 2023-04-21. Results received: No. Last updated: 2026-07-20.
Decision dates by country: AT: 2023-04-24, IE: 2023-05-26, FR: 2023-06-19, CZ: 2023-05-24, RO: 2023-04-25, HU: 2023-05-24, DE: 2023-04-21, BE: 2023-05-17, ES: 2023-05-17

Condition(s): Severe community-acquired pneumonia (sCAP)
Product: Placebo is a solution for infusion of 1% human albumin, it will be administrated via intravenous infusion., Trimodulin (human IgM, IgA, IgG solution)

Primary endpoint: Efficacy Endpoint: 28-day all-cause mortality rate
Endpoint(s): 90-day all-cause mortality rate, Change in Sequential Organ Failure Assessment (SOFA) score from baseline to day 7, Proportion of subjects with clinical cure of pneumonia up to day 29, Days of IMV up to day 29, Ventilator-free days (VFD) up to day 29, Days with oxygen supply up to day 29, Proportion of subjects with oxygen supply on days 7, 14, 21, 29, Days in intensive care unit (ICU) up to day 29, Time to discharge from ICU, Proportion of subjects in ICU on days 7, 14, 21 and 29, Days of hospitalization up to day 29, Time to discharge from hospital, Proportion of subjects in hospital on days 7, 14, 21 and 29, 28-day readmission rate, Rate of unscheduled return(s) to the emergency department or primary physician between day 29 and day 91, Time to return to normal activities up to day 91, Health status based on Clinical Frailty Scale (CFS) on day 91, Number, severity, causality, outcome, and seriousness of all adverse events (AEs) and treatment-emergent AEs (TEAEs), AEs of special interest (AESIs), infusional TEAEs, TEAEs that led to permanent discontinuation of IMP, and TEAEs that led to discontinuation of the trial through day 29 [+3], Number of all related TEAEs through day 91 [+10], Number, severity, causality, and outcome of all SAEs through day 29 [+3], Dose modifications (including reductions and changes in infusion rate), Distribution and changes over time of clinical laboratory vital signs parameters, and electrocardiogram (ECG), For subjects in main study: Changes from baseline, during and after treatment: Serum concentration of IgM, IgA, and IgG, For subjects in the PK substudy: Serum concentration of IgM, IgA, and IgG, For subjects in the PK substudy: Pharmacokinetic parameters of IgM, IgA and IgG, Changes from baseline, during and after treatment: Markers of inflammation, Markers of coagulation, Complement factors, Biomarkers, Anti-pathogen titers, Deterioration rate up to day 29

Source: https://euclinicaltrials.eu/ctis-public/view/2022-501352-28-00